EU clinical trial 2023-507469-24-00: A Phase 2, Open-Label, Ascending Dose Study of KER-050 for the Treatment of Anemia in Patients with Very Low, Low, or Intermediate Risk Myelodysplastic Syndromes (MDS)
Protocol code: KER050-MD-201
Sponsor: Takeda Development Center Americas Inc. (Pharmaceutical company). Phase: Therapeutic exploratory (Phase II). Countries: Spain (ongoing, recruitment ended), France (ongoing, recruiting), Germany (ongoing, recruitment ended), Czechia (ongoing, recruitment ended).
Therapeutic area(s): Diseases [C] - Hemic and Lymphatic Diseases [C15]
Gender: Female, Male. Age: 18-64 years, 65+ years. Enrolment: 56.
Start date (EU): 2022-04-30. Decision date: 2024-09-16. Results received: No. Last updated: 2026-03-31.
Decision dates by country: CZ: 2024-09-17, DE: 2024-09-20, ES: 2024-09-16, FR: 2024-09-20

Condition(s): Anemia in Patients with Very Low, Low, or Intermediate Risk Myelodysplastic Syndromes (MDS).
Product: elritercept

Primary endpoint: Part 1 and Part 2: • Safety and tolerability as determined by the incidence of treatment emergent adverse events(TEAEs) and serious adverse events (SAEs)., Long-term Extension: •Safety and tolerability as determined by the incidence of TEAEs and SAEs over time
Endpoint(s): Incidence of progression to higher risk MDS or AML per World Health Organization (WHO) 2016 criteria., Proportion of low transfusion burden (LTB) and high transfusion burden (HTB) participants who achieve red blood cell (RBC) transfusion independence (TI) ≥ 8 weeks, overall and by RS status., Proportion of participants who achieve modified 2006 International Working Group (IWG) Hematologic Improvement-Erythroid (HI E) response overall and by RS status (See Table 3 in Protocol KER050-MD-201 v 7.0)., Efficacy Endpoint: Proportion of participants who achieve overall erythroid response, defined as either HI-E or TI over any 8-week period, overall and by RS status, Efficacy Endpoint: Proportion of participants who achieve erythropoietic improvement overall and by RS status (See Table 3 in Protocol KER050-MD-201 v 7.0)., Efficacy Endpoint: Mean change from Baseline in Hgb by visit, Efficacy Endpoint: Time to HI-E response., Efficacy Endpoint: Duration of HI-E response., Efficacy Endpoint: Time to TI response., Efficacy Endpoint: Time to TI response., Efficacy Endpoint: Proportion of LTB and HTB participants who achieve TI ≥ 12 weeks, 16 weeks, 24 weeks, 48 weeks., Proportion of LTB and HTB participants who achieve TI ≥ 12 weeks, 16 weeks, 24 weeks, 48 weeks., Pharmacodynamic Endpoint: Change from baseline of red cell parameters, including reticulocyte count, mean corpuscular volume, mean corpuscular hemoglobin, and reticulocyte cell Hgb by visit.

Source: https://euclinicaltrials.eu/ctis-public/view/2023-507469-24-00